EU clinical trial 2023-504231-41-01: A Randomized Open-Label Phase 2/3 Study of BT8009 as Monotherapy or in Combination in Participants with Locally Advanced or Metastatic Urothelial Cancer (Duravelo-2)
Protocol code: BT8009-230
Sponsor: Bicycletx Limited (Pharmaceutical company). Phase: Therapeutic exploratory (Phase II). Countries: Germany (ongoing, recruitment ended), Italy (ongoing, recruitment ended), Denmark (ended), Austria (ended), France (ongoing, recruitment ended), Poland (ongoing, recruitment ended), Belgium (ongoing, recruitment ended), Spain (ongoing, recruitment ended), Hungary (ongoing, recruitment ended), Bulgaria (ended), Czechia (ended), Ireland (ended), Latvia (ended), Portugal (ended), Romania (ended), Netherlands (ended), Norway (ended), Greece (ended).
Therapeutic area(s): Diseases [C] - Neoplasms [C04]
Gender: Female, Male. Age: 18-64 years, 65+ years. Enrolment: 341.
Start date (EU): 2024-10-02. Decision date: 2024-09-16. Results received: No. Last updated: 2026-07-28.
Decision dates by country: NO: 2025-04-23, AT: 2024-09-29, PT: 2025-03-24, LV: 2025-04-25, GR: 2025-05-02, NL: 2025-04-23, RO: 2025-05-12, CZ: 2025-05-06, IE: 2025-05-09, DK: 2024-09-17, BG: 2025-05-12, BE: 2024-09-16, IT: 2024-09-17, ES: 2024-09-17, DE: 2024-09-20, HU: 2024-09-26, PL: 2024-09-30, FR: 2024-09-23

Condition(s): Locally advanced or metastatic urothelial cancer
Product: Zelenectide Pevedotin, AVELUMAB, CARBOPLATIN, GEMCITABINE, PEMBROLIZUMAB, BT8009, CISPLATIN

Primary endpoint: 1. (Cohort 1) PFS, measured by the length of time from date of randomization to date of first documentation of disease progression per RECIST v1.1 assessed by BICR or death (due to any cause), whichever occurs first., 2. (Cohort 2) PFS, measured by the length of time from randomization to first documentation of disease progression per RECIST v1.1 assessed by BICR or death (due to any cause), whichever occurs first., 3. (Cohort 2) ORR, measured by the percentage of participants who have achieved either confirmed CR or PR per RECIST v1.1 assessed by BICR.
Endpoint(s): 1. (Cohort 1) PFS, measured by the length of time from date of randomization to date of first documentation of disease progression per RECIST v1.1 assessed by BICR or death (due to any cause) whichever occurs first., 2. (Cohort 1) - ORR, measured by the percentage of participants who have achieved either a confirmed complete response (CR) or partial response (PR) per RECIST v1.1 assessed by BICR., 3. (Cohort 1) ORR, measured by the percentage of participants who have achieved either a confirmed complete response (CR) or partial response (PR) per RECIST v1.1 assessed by BICR., 1. (Cohort 2) DoR, measured by the time from first documentation of objective response (that is subsequently confirmed) per RECIST v1.1 assessed by BICR to date of first documented of disease progression (per RECIST v1.1), or to death (due to any cause), whichever occurs first., 2. (Cohort 2) DCR, measured by the percentage of participants who experience a confirmed CR, PR, or SD per RECIST v1.1 assessed by BICR., 3. (Cohort 2)OS, defined as length of time from date of randomization until the date of death from any cause.

Source: https://euclinicaltrials.eu/ctis-public/view/2023-504231-41-01